EU clinical trial 2025-523372-24-00: COMPARISON OF ZINC ACETATE DOSE REGIMENS (GALZIN VS. ET-700) FOR THE TREATMENT OF WILSON DISEASE: A PHARMACODYNAMIC 64CUCL2 PET/CT STUDY IN HEALTHY PARTICIPANTS
Sponsor: Region Midtjylland (Hospital/Clinic/Other health care facility). Phase: Therapeutic exploratory (Phase II). Countries: Denmark (ongoing, recruiting).
Therapeutic area(s): Diseases [C] - Nutritional and Metabolic Diseases [C18]
Gender: Female, Male. Age: 18-64 years, 65+ years. Enrolment: 36.
Status: Ongoing, recruiting. Start date (EU): 2026-03-10. Decision date: 2026-03-02. Results received: No. Last updated: 2026-03-02.

Condition(s): Wilson's Disease
Product: Galzin 50mg, ET-700 75 mg, Placebo, COPPER (64CU) CHLORIDE

Primary endpoint: The primary endpoint is the change in mean hepatic 64Cu standard uptake value (SUV) from pre- to post-intervention between the three groups.
Endpoint(s): Change in plasma zinc, total copper, exchangeable copper, and ceruloplasmin levels from pre- to post-intervention between the groups., Change in metallothionein (a protein related to homeostasis of e.g. zinc and copper) induction in peripheral blood mononuclear cells from pre- to post-intervention between the groups., Change in urinary zinc and copper levels from pre- to post-intervention between the groups., Number of AEs in the three groups.

Source: https://euclinicaltrials.eu/ctis-public/view/2025-523372-24-00